EU clinical trial 2023-509729-33-00: A First In Human Phase I Trial Evaluating safety, tolErability and ResponSe of [211At]At-Girentuximab (ATO-101™) in PatiEnts with Non-Muscle-InVasive BladdER CANCEr Refractory to Standard Treatment (PERSEVERANCE EU)
Protocol code: PERSEVERANCE EU
Sponsor: Institut De Cancerologie De L Ouest (Hospital/Clinic/Other health care facility). Phase: Human Pharmacology (Phase I)- First administration to humans. Countries: France (authorised, recruitment pending).
Therapeutic area(s): Diseases [C] - Neoplasms [C04]
Gender: Female, Male. Age: 18-64 years, 65+ years. Enrolment: 24.
Status: Authorised, recruitment pending. Decision date: 2025-11-26. Results received: No. Last updated: 2026-07-30.

Condition(s): Non-Muscle-Invasive Bladder Cancer (NMIBC) refractory

Source: https://euclinicaltrials.eu/ctis-public/view/2023-509729-33-00